EU clinical trial 2024-510887-22-00: A Placebo-Controlled, Double-Blind, Parallel-Group, 18 Month Study With an Open-Label Extension Phase to Confirm Safety and Efficacy of BAN2401 in Subjects With Early Alzheimer’s Disease
Protocol code: BAN2401-G000-301
Sponsor: Eisai Limited (Pharmaceutical company). Phase: Therapeutic confirmatory (Phase III). Countries: Sweden (ongoing, recruitment ended), Spain (ongoing, recruitment ended), Italy (ongoing, recruitment ended), Germany (ongoing, recruitment ended), France (ongoing, recruitment ended).
Therapeutic area(s): Diseases [C] - Nervous System Diseases [C10]
Gender: Female, Male. Age: 18-64 years, 65+ years. Enrolment: 348.
Status: Ongoing, recruitment ended. Start date (EU): 2019-09-30. Decision date: 2024-07-16. Results received: No. Last updated: 2026-08-06.
Decision dates by country: ES: 2024-07-16, DE: 2024-07-25, FR: 2024-07-25, SE: 2024-07-22, IT: 2024-07-24

Condition(s): Mild cognitive impairment due to Alzheimer's disease or mild Alzheimer's disease dementia.
Product: Lecanemab

Primary endpoint: Core - Change from baseline in the CDR-SB at 18 months., Extension - Incidence of AEs and changes in vital signs, ECGs, laboratory safety tests, suicidality assessments, ADAs, and MRI safety parameters. - Change from Core Study baseline in CDR-SB
Endpoint(s): The key secondary endpoints for this study are: - Change from baseline in amyloid PET using Centiloids at 18 months for brain amyloid levels - Change from baseline in ADAS-cog14 at 18 months - Change from baseline in ADCOMS at 18 months - Change from baseline in ADCS MCI-ADL at 18 months., OTHER SECONDARY ENDPOINTS: Refer to protocol., BM Endpoints: Refer to protocol.

Source: https://euclinicaltrials.eu/ctis-public/view/2024-510887-22-00